EU clinical trial 2023-504422-19-00: A study evaluating the safety, tolerability, and efficacy of GLPG5101 in adults with treatment-refractory active systemic lupus erythematosus
Protocol code: GLPG5101-CL-104
Sponsor: Galapagos (Pharmaceutical company). Phase: Human Pharmacology (Phase I)- Other. Countries: Netherlands (ended), Belgium (ended).
Therapeutic area(s): Diseases [C] - Immune System Diseases [C20]
Gender: Female, Male. Age: 18-64 years. Enrolment: 20.
Status: Ended. End date (EU): 2024-02-22. Decision date: 2023-10-02. Results received: No. Last updated: 2024-02-16.
Decision dates by country: NL: 2023-10-02, BE: 2023-10-03

Condition(s): Treatment-refractory active systemic lupus erythematosus

Source: https://euclinicaltrials.eu/ctis-public/view/2023-504422-19-00